EU clinical trial 2023-504226-18-00: A Phase III, Randomized, Double-Blind, Placebo-Controlled, Multicenter Basket Study to Evaluate the Efficacy, Safety, Pharmacokinetics, and Pharmacodynamics of Satralizumab in Patients with Anti-N-Methyl-D-Aspartic Acid Receptor (NMDAR) or Anti-Leucine-Rich Glioma-Inactivated 1 (LGI1) Encephalitis
Protocol code: WN43174
Sponsor: F. Hoffmann-La Roche AG (Pharmaceutical company). Phase: Therapeutic confirmatory (Phase III). Countries: Netherlands (ended), Denmark (ended), Italy (ongoing, recruitment ended), Czechia (ended), Austria (ended), France (ongoing, recruitment ended), Poland (ongoing, recruitment ended), Spain (ended).
Therapeutic area(s): Diseases [C] - Nervous System Diseases [C10]
Gender: Female, Male. Age: 0-17 years, 18-64 years, 65+ years. Enrolment: 47.
Start date (EU): 2022-11-30. Decision date: 2024-09-06. Results received: No. Last updated: 2026-01-15.
Decision dates by country: AT: 2024-09-08, FR: 2024-09-09, NL: 2024-09-10, PL: 2024-10-05, DK: 2024-09-06, CZ: 2024-09-09, ES: 2025-08-20, IT: 2024-09-17

Condition(s): NMDAR or LGI1 mediated autoimmune Encephalitis

Primary endpoint: 1. NMDAR AIE cohort: Proportion of participants with mRS score improvement >=1 from baseline and no use of rescue therapy at Week 24, 2. LGI1 AIE cohort: Proportion of participants with mRS score improvement >=1 from baseline and no use of rescue therapy at week 52
Endpoint(s): 1. NMDAR AIE cohort: Time to mRS score improvement >=1 from baseline without use of rescue therapy, 2. NMDAR AIE cohort: Time to rescue therapy, 3. NMDAR AIE cohort: Proportion of participants with sustained seizure cessation at Week 24, as defined by 4 consecutive weeks of no seizures maintained until Week 24, and no use of rescue therapy, 4. NMDAR AIE cohort: Change in CASE score from baseline at Week 24, 5. NMDAR AIE cohort: MOCA total score at Week 24, 6 . NMDAR AIE cohort: mRS score at Week 24 (as measured on a 7-point scale, 7. LGI1 AIE cohort: Time to mRS score improvement >=1 from baseline without use of rescue therapy, 8. LGI1 AIE cohort: Time to rescue therapy, 9. LGI1 AIE cohort: Proportion of participants with sustained seizure cessation at Week 24, as defined by 4 consecutive weeks of no seizures maintained until Week 24, and no use of rescue therapy, 10. LGI1 AIE cohort: Change in CASE score from baseline at Week 52, 11. LGI1 AIE cohort: MoCA total score at Week 52, 12. LGI1 AIE cohort: RAVLT score at Week 52, 13. Incidence, seriousness, and severity of adverse events, with severity determined according to National Cancer Institute Common Terminology Criteria for Adverse Events, Version 5.0, 14 . Change from baseline in targeted vital signs, clinical laboratory test results, electrocardiogram (ECG) results, weight, height (<18 years only), and Columbia-Suicide Severity Rating Scale (C-SSRS)

Source: https://euclinicaltrials.eu/ctis-public/view/2023-504226-18-00